EU clinical trial 2023-510278-14-00: Effects of N-Acetyl-L-Leucine on Niemann-Pick disease type C (NPC): A Phase III, randomized, placebo-controlled, double-blind, crossover study
Protocol code: IB1001-301
Sponsor: Intrabio Limited (Pharmaceutical company). Phase: Therapeutic confirmatory (Phase III). Countries: Germany (ongoing, recruiting), Netherlands (ongoing, recruiting), Czechia (ongoing, recruiting), Slovakia (ongoing, recruiting).
Therapeutic area(s): Diseases [C] - Congenital, Hereditary, and Neonatal Diseases and Abnormalities [C16]
Gender: Female, Male. Age: 0-17 years, 18-64 years. Enrolment: 60.
Status: Ongoing, recruiting. Start date (EU): 2022-06-16. Decision date: 2024-03-26. Results received: No. Last updated: 2025-11-27.
Decision dates by country: CZ: 2024-03-27, DE: 2024-03-27, NL: 2024-03-26, SK: 2024-03-26

Condition(s): Niemann-Pick disease type C
Product: Granules for oral suspension, N-Acetyl-L-Leucine

Primary endpoint: The primary endpoint for the study is of the Scale for the Assessment and Rating of Ataxia (SARA). In the US, the Modified SARA is the primary endpoint.
Endpoint(s): Spinocerebellar Ataxia Functional Index (SCAFI), Quality of Life EQ-5D-5L for patients aged ≥18; EQ-5D-Y for patients aged <18 years, Modified Disability Rating Scale (mDRS), Physician’s, Caregiver’s (if applicable), and Patient’s (if able) Clinical Global Impression of Improvement (CGI-I) comparing end of period I (Visit 4) to baseline (Visit 2), and end of period II (Visit 6) to end of period I (Visit 4

Source: https://euclinicaltrials.eu/ctis-public/view/2023-510278-14-00